EU clinical trial 2024-514919-10-00: Low dose cisplatin weekly versus high dose cisplatin every three weeks in primary chemoradiation in sarcopenic patients with head and neck squamous cell carcinoma
Sponsor: Universitair Medisch Centrum Utrecht (Hospital/Clinic/Other health care facility). Phase: Therapeutic use (Phase IV). Countries: Netherlands (ongoing, recruitment ended).
Therapeutic area(s): Diseases [C] - Neoplasms [C04]
Gender: Female, Male. Age: 18-64 years, 65+ years. Enrolment: 160.
Status: Ongoing, recruitment ended. Start date (EU): 2022-01-24. Decision date: 2024-11-11. Results received: No. Last updated: 2024-11-11.

Condition(s): Locally advanced head and neck squamous cell carcinoma
Product: Cisplatin Accord Healthcare 1 mg/ml concentraat voor oplossing voor infusie

Primary endpoint: The primary outcome parameter is compliance (non CDLT) rate to the proposed cisplatin scheme. Compliance to chemotherapy is defined as the absence of CDLT. CDLT is defined as any toxicity resulting in a cisplatin dose-reduction of ≥50%, a postponement of treatment of ≥4 days or a definite termination of cisplatin after the first or second cycle of therapy.
Endpoint(s): Secondary outcome parameters are adverse events/toxicity, cumulative cisplatin dose, time to recurrence, 2-year overall survival, costs, quality of life and patient's preference. The main oncological outcome parameters are time to recurrence and survival. Clinically relevant treatment related toxicity parameters, including specific toxicity that results in significant (grade 3 or 4) toxicity, treatment de-escalation or termination, will be recorded by the treating medical oncologist.Toxicity wi

Source: https://euclinicaltrials.eu/ctis-public/view/2024-514919-10-00